EU clinical trial 2023-509585-38-00: MEPENDAX: Phase I/II study of axitinib (Inlyta®) and oral metronomic etoposide for pediatric children and AYA with refractory/relapsing medulloblastoma and ependymoma
Protocol code: MEPENDAX
Sponsor: Assistance Publique Hopitaux De Marseille (Hospital/Clinic/Other health care facility). Phase: Phase I and Phase II (Integrated)- Other. Countries: France (ongoing, recruiting).
Therapeutic area(s): Diseases [C] - Neoplasms [C04]
Gender: Female, Male. Age: 0-17 years, 18-64 years. Enrolment: 40.
Status: Ongoing, recruiting. Start date (EU): 2024-11-19. Decision date: 2024-10-07. Results received: No. Last updated: 2026-04-29.

Condition(s): Ependymoma, Medulloblastoma
Product: Inlyta 1 mg film-coated tablets, Inlyta 3 mg film-coated tablets, CELLTOP 50 mg, capsule molle, ETOPOSIDE VIATRIS 20 mg/ml, solution à diluer pour perfusion

Primary endpoint: First stage: The Dose-Limiting Toxicity (DLT) will be assessed over the first 28-day cycles, according to the NCI CTCAE V5, Second stage: Progression-free survival (PFS) computed as the time interval from the date of beginning of treatment to the date of centrally-assessed progression or death from any cause. The progression will be based on the RAPNO criteria. A central review of all imaging will evaluate tumor response and progressions at end of dose escalation phase and at end of expansion phase. PFS will be censored at the date of last visit.
Endpoint(s): Adverse events (type, grade) graded according to the NCI CTCAE V5, per 28-day cycle and over the whole treatment duration. All AE occurring during treatment or in the 28 days after end of treatment will be reported, regardless of reported causal relationship, except symptoms related to the underlying disease or disease progression., Tumor response during treatment, centrally assessed using RAPNO criteria. The best overall response will be defined as the best response recorded from beginning of treatment until disease progression, Overall survival, computed as the time interval from the date of beginning of treatment to the date of death from any cause. Survival of patients alive at last follow-up will be censored at the date of last visit., Relative dose-intensity of the different drugs, estimated for each drug as the ratio between the computed dose-intensity (cumulative dose expressed in mg/m² divided by the study duration and expressed in mg/m²/week) and the protocol dose-intensity., First stage: Calculate PK parameters of oral axitinib combined with etoposide, Ancillary study: exploration of molecular signature in blood or CSF - Progression-free survival, defined as the time from randomization to recurrence, development of second primary cancer, or death from any cause. Overall survival defined as the time from randomization to death from any cause.

Source: https://euclinicaltrials.eu/ctis-public/view/2023-509585-38-00